EU clinical trial 2024-511359-16-00: The Effect of ColcHicine on the incidence of knee or hip replacements: a randomized, double-blind, multicentre study in symptomatic knee or hip Osteoarthritis – the ECHO trial
Sponsor: Sint Maartenskliniek (Hospital/Clinic/Other health care facility). Phase: Therapeutic confirmatory (Phase III). Countries: Netherlands (ongoing, recruiting).
Therapeutic area(s): Diseases [C] - Musculoskeletal Diseases [C05]
Gender: Female, Male. Age: 18-64 years, 65+ years. Enrolment: 1200.
Status: Ongoing, recruiting. Start date (EU): 2025-01-17. Decision date: 2024-11-04. Results received: No. Last updated: 2026-02-12.

Condition(s): Osteoarthritis
Product: Placebo, Colchicine Tiofarma 500 microgram Tablets

Primary endpoint: Time from randomization to the first incident of TKR/THR
Endpoint(s): Course of pain from randomization over the trial period, Course of physical function over the trial period, Radiological progression over the trial period, Change in low-grade inflammation at 1 year and end of the study, Course of quality of life over the trial period, Clinical or radiological onset of OA in new joint group other than hip and/or knee over the trial period, Use of pain medication during the study over the trial period, Onset of new cardiovascular events, defined as myocardial infarction, peripheral artery disease, ischemia-driven coronary revascularization, ischemic stroke, or cardiovascular death, Direct and indirect costs related to treatment and disease burden due osteoarthritis, Incidence and severity of adverse events throughout the study

Source: https://euclinicaltrials.eu/ctis-public/view/2024-511359-16-00